EU clinical trial 2023-503684-42-00: A phase II trial of 177Lutetium-DOTATATE in children with primary refractory or relapsed high-risk neuroblastoma LuDO-N
Protocol code: LuDO-N
Sponsor: Karolinska University Hospital (Hospital/Clinic/Other health care facility). Phase: Therapeutic exploratory (Phase II). Countries: Denmark (ongoing, recruitment ended), Norway (ongoing, recruitment ended), Lithuania (ongoing, recruitment ended), Netherlands (ongoing, recruitment ended), Sweden (ongoing, recruitment ended), Spain (ongoing, recruiting).
Therapeutic area(s): Diseases [C] - Nervous System Diseases [C10]; Diseases [C] - Neoplasms [C04]
Gender: Female, Male. Age: 0-17 years, 18-64 years. Enrolment: 24.
Start date (EU): 2026-02-20. Decision date: 2023-05-05. Results received: No. Last updated: 2026-05-14.
Decision dates by country: DK: 2023-05-09, LT: 2023-05-31, SE: 2023-05-05, NO: 2023-05-09, ES: 2024-10-18, NL: 2023-05-05

Condition(s): Neuroblastoma
Product: SomaKit TOC 40 micrograms kit for radiopharmaceutical preparation, LysaKare 25 g/25 g solution for infusion, Lutathera 370 MBq/mL solution for infusion

Primary endpoint: Response by the Revised International Neuroblastoma Response Criteria (INRC) at 1 month after the completion of therapy
Endpoint(s): Response based on 68Ga-DOTATOC PET/CT imaging at 1 and 4 months after completion of therapy in measurable target lesions, Response based on 123I-mIBG SPECT/CT imaging (when available) at 1 and 4 months after completion of therapy in measurable target lesions, Response by the Revised INRC criteria at 4 months after the completion of therapy, Progression free survival (PFS), Overall survival (OS), Hematological and renal toxicity according to CTCAE 5.0

Source: https://euclinicaltrials.eu/ctis-public/view/2023-503684-42-00